EU clinical trial 2023-505874-14-00: A Pilot Study to Assess the Use of Methylone in the Treatment of PTSD IMPACT-1 (Investigation of Methylone for Post-Traumatic Stress Disorder [PTSD])
Protocol code: TT-TSND-201
Sponsor: Transcend Therapeutics Inc. (Pharmaceutical company). Phase: Phase I and Phase II (Integrated)- Other. Countries: Ireland (ended).
Therapeutic area(s): Psychiatry and Psychology [F] - Mental Disorders [F03]
Gender: Female, Male. Age: 18-64 years, 65+ years. Enrolment: 16.
Status: Ended. Start date (EU): 2024-01-16. End date (EU): 2025-01-09. End date: 2025-02-19. Decision date: 2023-09-26. Results received: Yes. Last updated: 2025-02-14.

Condition(s): Post-Traumatic Stress Disorder (PTSD)
Product: Methylone - 50 mg - capsule, White Opaque Size 3 capsule containing Microcrystalline Cellulose (MCC)

Primary endpoint: Part A: Incidence and severity of TEAEs., Part A: Incidence and severity of AESIs., Part A: Change in HR, SBP, DBP and temperature, Part A: Clinically significant changes in ECG., Part A: Changes from baseline in clinical laboratory parameters (clinical chemistry, haematology and urinalysis)., Part B: Mean change from baseline to Week 10 compared with placebo in CAPS-5 total severity score.
Endpoint(s): Part A: Mean change from baseline to week 10 in CAPS-5 (total severity score assessed over 1 week), Part A: Percentage of participants having: - Treatment response, defined as a a. ≥ 10 point reduction on the CAPS-5 from baseline b. 30% improvement from baseline on CAPS-5 c. 50% improvement from baseline on CAPS-5 - Remission, defined as a score of ≤ 11 on the CAPS-5, Part A: Mean change from baseline in the following scales: - CGI-S - MADRS - SDS - PCL-5 - PGI-S - BDI-II - WEMWBS - PSQI, Part A: Percentage of participants with improvement on the following scales: - PGI-C -CGI-I, Part B: Mean change from baseline compared with placebo in the following scales: - CGI-S - MADRS - SDS - PCL-5 - PGI-S - BDI-II - WEMWBS - PSQI, Part B: Percentage of participants having: - Treatment response, defined as a a. ≥ 10 point reduction on the CAPS-5 from baseline b. 30% improvement from baseline on CAPS-5 c. 50% improvement from baseline on CAPS-5 - Remission, defined as a score of ≤ 11 on the CAPS-5 - Improvement on the PGI-C - Improvement on the CGI-I, Part B: Incidence and severity of TEAEs, Part B: Incidence and severity of AESIs, Part B: Change in HR, SBP, DBP and temperature during each dosing session, Part B: Clinically significant changes in ECG, Part B: Changes from baseline in clinical laboratory parameters (clinical chemistry, haematology, and urinalysis)

Source: https://euclinicaltrials.eu/ctis-public/view/2023-505874-14-00